EU clinical trial 2023-507544-37-00: Safety and efficacy of apixaban versus warfarin in peritoneal dialysis patients with non valvular atrial fibrillation: a randomized controlled trial
Protocol code: 23-0164 (APIDP2)
Sponsor: Centre Hospitalier Universitaire De Caen Normandie (Hospital/Clinic/Other health care facility). Phase: Therapeutic confirmatory (Phase III). Countries: France (ongoing, recruiting).
Therapeutic area(s): Phenomena and Processes [G] - Reproductive and Urinary Physiological Phenomena [G08]
Gender: Female, Male. Age: 18-64 years, 65+ years. Enrolment: 178.
Status: Ongoing, recruiting. Start date (EU): 2025-01-08. Decision date: 2024-05-24. Results received: No. Last updated: 2026-07-15.

Condition(s): patients with end-stage renal disease on chronic peritoneal dialysis and with non-valvular atrial fibrillation
Product: WARFARIN, APIXABAN, WARFARIN SODIUM

Primary endpoint: Clinically significant major or non-major bleeding [Period: from randomization to Month 12]. ISTH score (primary), Gusto, TIMI (secondary).
Endpoint(s): Stroke or systemic embolism [Period: From randomization until Month 12]., Myocardial infarction [Period: From randomization until Month 12]., Death from any cause [Period: From randomization until Month 12]., INR values, interpretation by Rosendaal method, antiXa activity of apixaban at M1, M6, M12, and in case of bleeding.

Source: https://euclinicaltrials.eu/ctis-public/view/2023-507544-37-00